EU clinical trial 2022-501925-19-00: A Phase II/III Randomized, Double-blind, Placebo-controlled, Multicenter Study to Determine the Efficacy and Safety of ABC008 in the Treatment of Subjects with Inclusion Body Myositis
Protocol code: ABC008-IBM-201
Sponsor: Abcuro Inc. (Pharmaceutical company). Phase: Phase II and Phase III (Integrated). Countries: Belgium (ended), Germany (ended), France (ended).
Therapeutic area(s): Diseases [C] - Musculoskeletal Diseases [C05]
Gender: Female, Male. Age: 18-64 years, 65+ years. Enrolment: 24.
Status: Ended. Start date (EU): 2024-01-17. End date (EU): 2025-11-25. End date: 2025-11-27. Decision date: 2023-11-06. Results received: Yes. Last updated: 2026-03-17.
Decision dates by country: BE: 2023-11-06, FR: 2023-11-07, DE: 2023-11-07

Condition(s): inclusion body myositis
Product: Placebo to Test Product, Ulviprubart

Primary endpoint: For Part B: The primary endpoint of the study will be mean change from Baseline (Day 1) in IBMFRS at W76. For Part C: The endpoint for Part C of the study will be PD recovery as assessed by the time from EOT/ETV to recovery of KLRG1+ cells.
Endpoint(s): Efficacy: 1. Mean change from Baseline (Day 1) in MMT 12 at W76; 2. Mean change from Baseline (Day 1) in hand grip strength by dynamometry at W76; Safety: 1. Incidence, nature, and severity of TEAEs; 2. Incidence, nature, and severity of TESAEs; Please refer to protocol for a complete list of the efficacy and safety secondary Endpoints.

Source: https://euclinicaltrials.eu/ctis-public/view/2022-501925-19-00